EU clinical trial 2024-514634-20-00: Characterization of Immune Response in Participants from a Posdinemab Study
Protocol code: NOPRODALZ0005
Sponsor: Janssen Cilag International (Pharmaceutical company). Phase: Human Pharmacology (Phase I)- Other. Countries: Netherlands (ended), Spain (ended), France (ended).
Therapeutic area(s): Diseases [C] - Nervous System Diseases [C10]
Gender: Female, Male. Age: 18-64 years, 65+ years. Enrolment: 20.
Status: Ended. Start date (EU): 2025-02-25. End date (EU): 2026-01-08. End date: 2026-01-09. Decision date: 2024-12-16. Results received: No. Last updated: 2025-05-23.
Decision dates by country: FR: 2024-12-16, ES: 2024-12-16, NL: 2024-12-20

Condition(s): Early Alzheimer's disease

Source: https://euclinicaltrials.eu/ctis-public/view/2024-514634-20-00